EU clinical trial 2023-510127-30-00: Multicenter, Phase Ib/IIa Study on the Safety and Efficacy of Autologous Peptide-coupled Red Blood Cells in Patients with Relapsing Remitting Multiple Sclerosis
Protocol code: MSB-IG-H-2101
Sponsor: Cellerys AG (Pharmaceutical company). Phase: Human Pharmacology (Phase I)- First administration to humans. Countries: Italy (ended), Germany (ended), Czechia (ended).
Therapeutic area(s): Diseases [C] - Nervous System Diseases [C10]
Gender: Female, Male. Age: 18-64 years. Enrolment: 9.
Status: Ended. Start date (EU): 2024-04-17. End date (EU): 2025-12-23. End date: 2025-12-24. Decision date: 2024-09-19. Results received: Yes. Last updated: 2025-11-28.
Decision dates by country: DE: 2024-09-25, CZ: 2024-09-19, IT: 2024-10-01

Condition(s): Relapsing Remitting Multiple Sclerosis (RRMS)
Product: Autologous uncoupled red blood cells (RBCs)

Primary endpoint: Safety endpoint: Safety and tolerability of CLS12311 measured by the number and severity of treatment-emergent adverse events (TEAEs) and treatment-emergent serious adverse events (TESAEs) and/or worsening of disease by clinical (relapses) and imaging (number and size of MRI brain lesions). MRIs will be assessed centrally by independent readers.
Endpoint(s): [Safety endpoints]: Number and severity of TEAEs and TESAEs in each dose group, [Safety endpoints]: Number of confirmed relapses in the treatment phase in each dose group, [Safety endpoints]: Changes in clinical measures of disease severity (EDSS, 9-HPT, T25- FW, SDMT) following CLS12311 administration in each dose group, [Exploratory immunological and biomarker measures]: Percentage of patients in each dose group showing a reduction of antigen-specific T cells against the protein(s) they responded to at the study entry, [Exploratory immunological and biomarker measures]: Changes in predefined serum- and cellular biomarkers including autoantigen-specific T cell responses that would indicate proinflammatory activation

Source: https://euclinicaltrials.eu/ctis-public/view/2023-510127-30-00